EU clinical trial 2024-516328-32-00: CANDIDATE THERAPIES IN COMBINATION OR SEQUENTIALLY WITH TYROSINE KINASE INHIBITORS IN CHRONIC PHASE CHRONIC MYELOGENOUS LEUKAEMIA (CP-CML) PATIENTS IN COMPLETE CYTOGENETIC RESPONSE WITHOUT ACHIEVING A DEEP MOLECULAR RESPONSE: AN ADAPTIVE TRIAL BASED ON A DROP LOSER DESIGN - ACTIW STUDY
Protocol code: P13/12
Sponsor: Centre Hospitalier De Versailles (Hospital/Clinic/Other health care facility). Phase: Therapeutic exploratory (Phase II). Countries: France (authorised, recruiting).
Therapeutic area(s): Diseases [C] - Hemic and Lymphatic Diseases [C15]
Gender: Female, Male. Age: 18-64 years, 65+ years. Enrolment: 250.
Status: Authorised, recruiting. Start date (EU): 2024-09-16. Decision date: 2024-09-16. Results received: No. Last updated: 2024-09-16.

Condition(s): CHRONIC PHASE CHRONIC MYELOGENOUS LEUKAEMIA (CP-CML)
Product: Actos 15 mg tablets, AVELUMAB

Primary endpoint: The primary end-point is the cumulative incidence of patients achieving a deep molecular response defined by MR4.5 or deeper (BCR-ABLIS ≤ 0.0032 %) by 12 months.
Endpoint(s): Adverse events, The cumulative rate of patients achieving MR4.5 by 24, 36, 48 months in experimental and control arms, The cumulative rate of patients achieving MR4 by 12, 24, 36, 48 months in experimental and control arms, The cumulative rate of patients with undetectable BCR-ABL1 transcript (sensitivity 40000 ABL copies) by 12, 24, 36, 48 months in experimental and control arms, The rate of patients in treatment free remission during follow-up, Measurement of number and clonogenicity of CML stem cells using the leukemic stem cell markers followed by flow cytometry analysis and the LTC-IC assay and others markers (ancillary study), Survival, progression free survival, event free survival, duration of response

Source: https://euclinicaltrials.eu/ctis-public/view/2024-516328-32-00